EU clinical trial 2024-516481-11-00: A Phase 3, Randomized, Open-Label, Controlled Study of Cabozantinib (XL184) in Combination with Atezolizumab vs Second Novel Hormonal Therapy (NHT) in Subjects with Metastatic Castration-Resistant Prostate Cancer
Protocol code: XL184-315
Sponsor: Exelixis Inc. (Pharmaceutical company). Phase: Therapeutic confirmatory (Phase III). Countries: Spain (ongoing, recruitment ended), Poland (ended), Germany (ended), Portugal (ended), Czechia (ended), Belgium (ongoing, recruitment ended), France (ongoing, recruitment ended), Greece (ended), Italy (ongoing, recruitment ended).
Therapeutic area(s): Diseases [C] - Neoplasms [C04]
Gender: Male. Age: 18-64 years, 65+ years. Enrolment: 203.
Start date (EU): 2020-09-22. Decision date: 2024-08-28. Results received: No. Last updated: 2026-03-24.
Decision dates by country: PT: 2024-08-28, IT: 2024-10-09, PL: 2024-09-02, GR: 2024-11-13, FR: 2024-09-02, BE: 2024-09-02, CZ: 2024-08-30, DE: 2024-08-30, ES: 2024-08-30

Condition(s): Metastatic Castration-Resistant Prostate Cancer
Product: Decortin® 5 mg Tabletten, ENZALUTAMIDE, ABIRATERONE ACETATE, Tecentriq 1 200 mg concentrate for solution for infusion, Prednison 5 mg GALEN® Tabletten, CABOMETYX 20 mg film-coated tablets, Prednison acis 5 mg, Tabletten

Primary endpoint: Duration of PFS per RECIST 1.1 per BIRC, Duration of OS
Endpoint(s): ORR per RECIST 1.1 per BIRC

Source: https://euclinicaltrials.eu/ctis-public/view/2024-516481-11-00